EU clinical trial 2024-511580-28-02: RECLAIM: an Adaptive Platform Trial for the Evaluation of Treatments for Post-Acute Sequelae of SARS-CoV-2 Infection (PASC)
Sponsor: Universitair Medisch Centrum Utrecht (Hospital/Clinic/Other health care facility). Phase: Therapeutic confirmatory (Phase III). Countries: Netherlands (ongoing, recruiting).
Therapeutic area(s): Diseases [C] - Virus Diseases [C02]
Gender: Female, Male. Age: 18-64 years, 65+ years. Enrolment: 2000.
Status: Ongoing, recruiting. Start date (EU): 2025-02-20. Decision date: 2025-02-07. Results received: No. Last updated: 2025-09-04.

Condition(s): PASC: post-acute sequelae of SARS-CoV-2 infection
Product: METFORMIN, COLCHICINE, MINOCYCLINE, Placebo tablets are identical to active minocycline tablets and will be relabelled identical to the study drug. Placebo tablets will have the same composition, except for the active substance. (microcrystalline cellulose, magnesium stearate).

Primary endpoint: Assessed at 12 weeks (end of trial product use period): Patient-Reported Outcomes Measurement Information System Profile29 (PROMIS-29) physical health summary score
Endpoint(s): Assessed at 12 weeks: ● PROMIS-29 mental health summary score ● PROMIS-29 domain scores: physical function, fatigue, pain interference, depressive symptoms, anxiety, ability to participate in social roles and activities, sleep disturbance., Assessed at 12 weeks: ● Checklist Individual Strength (CIS-8) ● DePaul Symptom Questionnaire (DSQ-2) PEM questions ● PROMIS cognitive function 8a ● DSQ-2 POTS questions, Assessed at 12 weeks: ● Frequency of related and unrelated (S)AEs in each IP arm compared to its control arm including their severity and outcome., Assessed at 12 weeks: ● Level of adherence to each IP versus the matching placebo control (if available). ● Percent of participants with adequate adherence for the specific IP., Assessed at 24 weeks (12 weeks after cessation of IP use): The proportion of participants that maintain HRQoL treatment success at 12 weeks., Exploratory: Same as above but stratified by phenotype., Exploratory: Same as above but stratified by pre-enrolment PASC symptom(s) duration., Exploratory: Described in relevant TSAs., Exploratory: Described in relevant TSAs.

Source: https://euclinicaltrials.eu/ctis-public/view/2024-511580-28-02